EU clinical trial 2024-511631-10-00: A phase I/II b (randomized controlled) study of atezolizumab combined to BEGEV regimen as first salvage treatment in patients with relapsed or refractory Hodgkin’s lymphoma candidate to autologous stem–cell transplantation
Sponsor: Fondazione Italiana Linfomi Ets (Patient organisation/association). Phase: Phase I and Phase II (Integrated)- Other. Countries: Italy (ongoing, recruiting).
Therapeutic area(s): Diseases [C] - Hemic and Lymphatic Diseases [C15]
Gender: Female, Male. Age: 18-64 years, 65+ years. Enrolment: 140.
Status: Ongoing, recruiting. Start date (EU): 2023-02-27. Decision date: 2024-11-12. Results received: No. Last updated: 2026-05-11.

Condition(s): Hodgkin’s lymphoma
Product: VINORELBINE, GEMCITABINE, BENDAMUSTINE, ATEZOLIZUMAB, VINORELBINE TARTRATE, GEMCITABINE, BENDAMUSTINE HYDROCHLORIDE

Primary endpoint: Phase I: Phase I: A DLT defined as any of these events occurring during C1 (initial 21 days): - G4 neutropenia leading to delay of next cycle of >14 days; - G4 thrombocytopenia or anemia leading to delay in the of the next cycle of >14 days; - G3 or 4 neutropenia with a fever>38.5 °C and/or infection requiring antibiotic or anti-fungal treatment for >14 days; - G≥3 non-hematologic toxicity persisting for >14 days and not related to study disease; -G≥3 infusion-related toxicities; G≥3 AESIs., Phase IIb: CRR will be defined as the proportion of patients in CR after the first 4 cycles of induction treatment, according to Lugano classification response Criteria and LYRIC 2016 criteria (Appendix D). Patients without response assessment (due to whatever reason) will be considered as non-responders.
Endpoint(s): Pahse IIb: ORR, PR, SD, PD rate will be defined according to the Lugano 2014 criteria and LYRIC 2016 criteria., Phase IIb: number of PR converted in CR., Phase IIb: Adequate stem cells mobilization will be defined by the target cell harvesting of 3 x 106 CD34+ cells/kg., Pahse IIb: Engraftment in patients receiving ASCT will be defined as the first of three consecutive days of achieving a sustained peripheral blood neutrophil count of >500 × 106/L (Wolff et al. 2002). Platelet engraftment is usually defined as independence from platelet transfusion for at least 7 days with a platelet count of more than >20 × 109/L (Teltschik et al. 2016)., Phase IIb: DoR will be defined as the time from date of documented tumor response (CR) until lymphoma relapse or progression., Pahse IIb: PFS will be defined as the time from beginning of therapy until lymphoma relapse or progression or death as a result of any cause; responding patients and patients who are lost to follow up will be censored at their last assessment date. OS will be defined as the time from beginning of therapy until death as a result of any cause; alive patients and those who are lost to follow up will be censored at their last assessment date., Phase IIb: measurement of: patients’ withdrawal rate, incidence, type and grade of any adverse event (AE) and serious adverse event (SAE), hospitalization rate (except it for study therapy administration), throughout the study., Phase IIb: SUVmax, tMTV (total Metabolic Tumor Volume), TLG (Total Lesion Glycolysis), Dmax and Radiomics features extrapolated by PET scans

Source: https://euclinicaltrials.eu/ctis-public/view/2024-511631-10-00